EU clinical trial 2024-515737-14-00: CLADRIBINE DOSE ESCALATION IN CONDITIONING REGIMEN PRIOR TO ALLOGENEIC HEMATOPOIETIC STEM CELL TRANSPLANTATION (Allo-HSCT) FOR REFRACTORY ACUTE LEUKEMIA AND MYELODYSPLASTIC SYNDROMES
Protocol code: CEREAL-IPC 2016-010
Sponsor: Institut Paoli Calmettes (Hospital/Clinic/Other health care facility). Phase: Human Pharmacology (Phase I)- Other. Countries: France (ongoing, recruiting).
Therapeutic area(s): Diseases [C] - Immune System Diseases [C20]; Diseases [C] - Neoplasms [C04]
Gender: Female, Male. Age: 18-64 years, 65+ years. Enrolment: 29.
Status: Ongoing, recruiting. Start date (EU): 2024-10-07. Decision date: 2024-10-07. Results received: No. Last updated: 2026-05-21.

Condition(s): Acute leukemia and myelodysplastic syndromes

Source: https://euclinicaltrials.eu/ctis-public/view/2024-515737-14-00